EU clinical trial 2025-522757-19-00: A Cancer Research UK Phase II trial of CY-101 given via intratumoural administration in locally advanced or metastatic adrenocortical carcinoma (CLARITY)
Protocol code: CRUKD/25/001
Sponsor: Cancer Research UK (Patient organisation/association). Phase: Therapeutic exploratory (Phase II). Countries: Spain (authorised, recruitment pending), France (authorised, recruitment pending), Germany (authorised, recruitment pending), Norway (authorised, recruitment pending).
Therapeutic area(s): Diseases [C] - Neoplasms [C04]
Gender: Female, Male. Age: 18-64 years, 65+ years. Enrolment: 26.
Status: Authorised, recruitment pending. Decision date: 2026-07-27. Results received: No. Last updated: 2026-07-31.
Decision dates by country: FR: 2026-07-31, DE: 2026-07-30, ES: 2026-07-31, NO: 2026-07-27

Condition(s): LOCALLY ADVANCED OR METASTATIC ADRENOCORTICAL CARCINOMA
Product: CY-101, CY-101

Primary endpoint: Phase IIa: Determining an optimal dose of CY-101 based upon review of all clinically relevant data including but not limited to toxicity, efficacy, quality of life data and PK parameters, Phase IIb: ORR defined as the proportion of participants who achieve CR or PR according to itRECIST.
Endpoint(s): Phase IIa & IIb: Frequency and causality of AEs, including relatedness, seriousness, severity, and those leading to interruption, or discontinuation of IMP, graded according to NCI CTCAE Version 5.0., Phase IIb: ORR defined as the proportion of participants who achieve iCR or iPR according to iRECIST., Phase IIb :Duration of response: defined as the time from date of first confirmed CR or PR according to itRECIST or iCR or iPR according to iRECIST to date of disease progression or death from any cause., Phase IIb : Disease control rate: defined as best response of CR, PR or SD (SD ≥12 weeks) according to itRECIST and iCR, iPR or iSD (iSD ≥12 weeks) according to iRECIST., Phase IIb: PFS: defined as the time from date of first dose of CY-101 to date of disease progression or date of death from any cause, Phase IIb: PFS at 18 weeks., Phase IIb: OS: defined as time from date of first dose to date of death from any cause., Phase IIb: OS at 6 and 12 months., Phase IIb: Growth modulation index: defined as the ratio of PFS on trial to PFS from previous treatment., Phase IIb: Time to next treatment: defined as the interval from commencement of CY-101 on the trial to initiation of the next line of therapy., Phase IIa & IIb: Change from baseline at each visit in participant reported quality of life outcomes using EORTC QLQ-C30., Phase IIa & IIb: PK parameters including where possible: Cmax, AUC, Tmax, T1/2, CL and Vd.

Source: https://euclinicaltrials.eu/ctis-public/view/2025-522757-19-00